EU clinical trial 2025-521917-24-00: A Phase 3, Randomized, Open-Label, Multicenter Study of Amivantamab in Addition to Carboplatin and Pembrolizumab, Compared to Standard of Care Platinum and Pembrolizumab and 5-FU, in Participants with Treatment-Naïve Recurrent/Metastatic Head and Neck Squamous Cell Carcinoma
Protocol code: 61186372HNC3001
Sponsor: Janssen Cilag International (Pharmaceutical company). Phase: Therapeutic confirmatory (Phase III). Countries: Italy (ongoing, recruiting), Portugal (ongoing, recruiting), Spain (ongoing, recruiting), Romania (ongoing, recruiting), Hungary (ongoing, recruiting), France (ongoing, recruiting), Czechia (ongoing, recruiting), Germany (ongoing, recruiting), Netherlands (ongoing, recruiting), Austria (ongoing, recruiting), Poland (ongoing, recruiting), Belgium (ongoing, recruiting).
Therapeutic area(s): Diseases [C] - Neoplasms [C04]
Gender: Female, Male. Age: 18-64 years, 65+ years. Enrolment: 192.
Status: Ongoing, recruiting. Start date (EU): 2026-01-21. Decision date: 2026-01-14. Results received: No. Last updated: 2026-02-25.
Decision dates by country: AT: 2026-01-18, BE: 2026-01-16, CZ: 2026-01-16, FR: 2026-01-14, DE: 2026-01-16, RO: 2026-01-19, ES: 2026-01-16, NL: 2026-01-16, PL: 2026-01-19, IT: 2026-01-16, PT: 2026-01-16, HU: 2026-01-15

Condition(s): Treatment-Naïve Recurrent/Metastatic Head and Neck Squamous Cell Carcinoma
Product: CARBOPLATIN, FLUOROURACIL, JNJ-61186372, CISPLATIN, PEMBROLIZUMAB

Primary endpoint: Overall Survival (OS)
Endpoint(s): 1. PFS (using RECIST v1.1), as assessed by BICR, 2. ORR as assessed by BICR, 3. DOR as assessed by BICR, 4. ORR as assessed by the investigator, 5. Incidence and severity of TEAEs and laboratory abnormalities, 6. Proportion of participants with improved or stable symptoms relative to baseline, as measured by the EORTC QLQ-HN43 and symptom scales of the EORTC QLQ-C30, 7. Change from baseline in functioning and overall HRQoL, as measured by functioning and global health scales of the EORTC QLQC30, 8. Differences between treatment groups in the EORTC IL46 tolerabilityscale scores, 9. Serum amivantamab concentrations and serum anti-amivantamab antibodies

Source: https://euclinicaltrials.eu/ctis-public/view/2025-521917-24-00